EU clinical trial 2023-506701-18-00: Evaluation of the bioavailability of two products containing esomeprazole under fasting and fed conditions: Esomeprazole-Syrup 40 mg dose (Test) vs. Nexium 40 mg (Comparator). A monocentric, open, randomized, single dose, four-period, crossover trial in healthy volunteers
Protocol code: CBP23001
Sponsor: CCDRD Cooperative Clinical Drug Research and Development AG, BePharBel Manufacturing (Pharmaceutical company). Phase: Human Pharmacology (Phase I)- Other. Countries: Bulgaria (ended).
Therapeutic area(s): Diseases [C] - Digestive System Diseases [C06]
Gender: Female, Male. Age: 18-64 years. Enrolment: 18.
Status: Ended. Start date (EU): 2024-03-27. End date (EU): 2024-04-23. Decision date: 2024-03-19. Results received: No. Last updated: 2024-03-19.

Condition(s): No therapeutic indication in the current trial with healthy volunteers.

Source: https://euclinicaltrials.eu/ctis-public/view/2023-506701-18-00